EU clinical trial 2024-516838-35-00: A Phase I dose finding study of MB-CART2219.1 targeting CD19/CD22 in adult and pediatric patients with relapsed/refractory B-cell malignancies
Protocol code: MBCART2219.1
Sponsor: Universitaetsklinikum Tuebingen AöR (Hospital/Clinic/Other health care facility). Phase: Human Pharmacology (Phase I)- First administration to humans. Countries: Germany (ongoing, recruiting).
Therapeutic area(s): Diseases [C] - Neoplasms [C04]
Gender: Female, Male. Age: 0-17 years, 18-64 years, 65+ years. Enrolment: 36.
Status: Ongoing, recruiting. Start date (EU): 2025-06-23. Decision date: 2025-04-01. Results received: No. Last updated: 2025-04-01.

Condition(s): Patients with relapsed/refractory Lymphoma or ALL aged ≥ 3 years
Product: MB-CART2219.1, MB-CART2219.1, MB-CART2219.1, MB-CART2219.1

Primary endpoint: The objective of this trial is to assess feasibility, safety and preliminary efficacy of ex vivo generated MB-CART2219.1 in patients with relapsed or refractory CD19 and/or CD22 positive B cell malignancies.
Endpoint(s): Disease Response (ORR, PR, CR) at 6 months, Dose/Response Relation, Progression free and overall survival, Non-Relapse Mortality, Progression-free survival on next line of treatment (PFS-2), Expansion of CAR+ T cells in the peripheral blood and if applicable bone marrow, CSF or other body fluids by flow cytometry, Evaluate the level of CD19/CD22-expressing malignant cells in tumor tissue, and if applicable peripheral blood and bone marrow, Evaluate the immunophenotype and/or expression profile of MB-CART2219.1 cells and endogenous immune and other hematopoietic cells in the peripheral blood, the bone marrow and/or tumor tissue., Evaluate levels of cytokines, chemokines, and soluble factors in the blood of subjects at baseline and after infusion of MB-CART2219.1 cells, Evaluate mechanisms of tumor sensitivity/resistance to MB-CART2219.1 cells, Evaluate the development of an anti-CAR cellular immune response after infusion of MB-CART2219.1 cells

Source: https://euclinicaltrials.eu/ctis-public/view/2024-516838-35-00